EU clinical trial 2024-511229-79-00: Normal saline versus lactated Ringer’s solution for fluid administration in acute pancreatitis, an open-label multicenter randomized controlled trial: the WATERLAND trial
Sponsor: Semmelweis University (Educational Institution). Phase: Therapeutic use (Phase IV). Countries: Hungary (authorised, recruitment pending).
Therapeutic area(s): Diseases [C] - Digestive System Diseases [C06]
Gender: Female, Male. Age: 18-64 years, 65+ years. Enrolment: 720.
Status: Authorised, recruitment pending. Decision date: 2024-05-17. Results received: No. Last updated: 2024-05-17.

Condition(s): Acute Pancreatitis
Product: Ringer Laktát Hartmann „Baxter” oldatos infúzió, Nátrium-klorid EUROLIFE 0,9% oldatos infúzió

Primary endpoint: The primary outcome will be moderately severe to severe AP, according to the revision of the Atlanta classification. The primary safety outcome will be a composite variable involving any of the following: fluid overload, acute kidney injury, hyperkalemia, hypercalcemia, or acidosis.

Source: https://euclinicaltrials.eu/ctis-public/view/2024-511229-79-00